EU clinical trial 2024-515568-30-00: Double blind, multicentre, randomized, placebo-controlled trial to evaluate safety and efficacy of pitolisant in children from 6 to less than 18 years with narcolepsy with/without cataplexy, followed by a prolonged open-label period
Protocol code: P11-06
Sponsor: Bioprojet Pharma (Pharmaceutical company). Phase: Therapeutic confirmatory (Phase III). Countries: Italy (ended), France (ended).
Therapeutic area(s): Diseases [C] - Nervous System Diseases [C10]
Gender: Female, Male. Age: 0-17 years. Enrolment: 57.
Status: Ended. End date (EU): 2025-06-05. Decision date: 2024-12-05. Results received: Yes. Last updated: 2025-06-03.
Decision dates by country: IT: 2025-01-23, FR: 2025-01-23

Condition(s): Narcolepsy
Product: Matches test film-coated tablets, Wakix 4.5 mg film-coated tablets, Wakix 18 mg film-coated tablets

Primary endpoint: Changes in UNS (Ullanlinna Narcolepsy Scale) measuring the intensity and frequency of symptoms of narcolepsy (Excessive Daytime Sleepiness and cataplexies), based on the change from baseline (mean of two pre-treatment measures at [(V1 + V2)/2]) of the UNS score and at the end of double-blind phase (mean of the last two measures [(V6 + V7)/2]).
Endpoint(s): Changes in EDS as measured by the maintenance of wakefulness test (MWT) between baseline and V7, Changes in EDS measured by the Paediatric Daytime Sleepiness Scale (PDSS) between baseline: [V1 score (D-14) + V2 score (D0)]/2 and the end of treatment: [V6 score (D49) + V7 score (D56)]/2, Changes in EDS as measured by the Child and Adolescent Sleepiness Scale (CASS) between baseline and the end of treatment, Changes in the average number of cataplexy episodes per weeks: (recorded in sleep diary by patient and/or parent/teacher) between the 2 weeks of baseline and the 2 weeks of end study treatment period (V6, V7), Differences in weekly frequency of cataplexy episodes (recorded in sleep diary by patient and/or parent/teacher) between baseline and the 4 weeks of stable treatment period (V5 to V7), Severity of EDS measured by the clinical Global Impression of severity and change. Changes between baseline and V6, V7, Severity of cataplexy measured by the clinical Global Impression of severity and change. Changes between baseline and V6, V7, Changes between baseline and V6 will be compared for the TEA-Ch test, Comparison between placebo and pitolisant groups on withdrawal symptoms questionnaire (DSM IV) on D59 during a phone call (T1) and at the end-of-study visit on D63 (V8) after a one-week period on placebo, Comparison between placebo and pitolisant groups on Patients’ Global Opinion on treatment effect at the end of treatment if able to express himself. If not will be reported either by parents or teachers, Comparison between placebo and pitolisant groups on Tolerability as measured by Treatment Emergent Adverse Events, Comparison between placebo and pitolisant groups on Changes in Physical examination and Vital signs, Comparison between placebo and pitolisant groups on ECG and calculation of Fridericia’s corrected QTc interval, Comparison between placebo and pitolisant groups on Blood laboratory tests (haematology, blood chemistry), Comparison between placebo and pitolisant groups on Mood appraisal adapted to children (CDI and C-SSRS), Changes between baseline and at each visit of the open-label period in EDS, Safety assessment will be done on monitoring of adverse events, physical examination, vital signs, ECG and Blood Laboratory tests modifications and the mood appraisal throughout the study.

Source: https://euclinicaltrials.eu/ctis-public/view/2024-515568-30-00